EU clinical trial 2022-501097-19-00: A randomized, double-blind, placebo-controlled, multi-center study to evaluate the efficacy, safety, tolerability, pharmacokinetics, and pharmacodynamics of orally administered GLPG3667 once daily for 24 weeks in adult subjects with dermatomyositis
Protocol code: GLPG3667-CL-214
Sponsor: Galapagos (Pharmaceutical company). Phase: Therapeutic exploratory (Phase II). Countries: Germany (ended), Italy (ended), Romania (ended), France (ended), Bulgaria (ended), Croatia (ended), Belgium (ended), Spain (ended), Czechia (ended), Poland (ended).
Therapeutic area(s): Phenomena and Processes [G] - Immune system processes [G12]
Gender: Female, Male. Age: 18-64 years, 65+ years. Enrolment: 32.
Status: Ended. Start date (EU): 2023-08-09. End date (EU): 2026-04-20. End date: 2026-04-20. Decision date: 2023-05-12. Results received: No. Last updated: 2026-04-29.
Decision dates by country: PL: 2023-05-22, HR: 2023-05-15, BE: 2023-05-17, CZ: 2023-05-17, BG: 2023-05-15, DE: 2024-08-22, RO: 2023-05-15, ES: 2023-05-22, FR: 2023-05-15, IT: 2023-05-12

Condition(s): dermatomyositis
Product: placebo, GLPG3667

Primary endpoint: Total improvement score [TIS] according to the American College of Rheumatology (ACR)/European League Against Rheumatism (EULAR) criteria at Week 24. Open Label Extension : Frequency and severity of TEAEs, treatment-emergent SAEs, and TEAEs leading to treatment discontinuation (over time up to Week 52).
Endpoint(s): At week 24 - - Proportion of subjects with at least minimal improvement according to the ACR/EULAR criteria (defined as TIS of >= 20 points) at Week 24. - Change from baseline in modified-Cutaneous DM Disease Area and Severity Index Activity Score (m-CDASI-A). - Change from baseline in Health Assessment Questionnaire-Disability Index (HAQ-DI) - Change from baseline in the manual muscle test (MMT-8), Frequency and severity of treatment-emergent adverse events (TEAEs), treatment-emergent serious adverse events (SAEs), and TEAEs leading to treatment discontinuation (over time up to Week 24)., Estimated GLPG3667 maximum plasma concentration (Cmax), area under the plasma concentration-time curve (AUC), and trough plasma concentration (Ctrough) at steady-state.

Source: https://euclinicaltrials.eu/ctis-public/view/2022-501097-19-00